EU clinical trial 2022-502844-11-00: C0371002 - Phase 3, open label, single arm study to evaluate efficacy and safety of FIX gene transfer with PF-06838435 (rAAV-Spark100-hFIX-R338L) in adult male participants with moderately severe to severe hemophilia B (FIX:C≤2%) (BeneGene-2)
Protocol code: C0371002
Sponsor: Pfizer Inc. (Pharmaceutical company). Phase: Therapeutic confirmatory (Phase III). Countries: France (ongoing, recruitment ended), Sweden (ongoing, recruitment ended), Greece (ongoing, recruitment ended), Germany (ongoing, recruitment ended), Belgium (ended), Italy (ongoing, recruitment ended), Spain (ongoing, recruitment ended).
Therapeutic area(s): Diseases [C] - Hemic and Lymphatic Diseases [C15]
Gender: Male. Age: 18-64 years. Enrolment: 26.
Start date (EU): 2020-01-29. Decision date: 2023-06-16. Results received: No. Last updated: 2026-07-10.
Decision dates by country: BE: 2024-04-17, GR: 2023-07-07, IT: 2024-03-11, SE: 2023-06-16, DE: 2023-08-01, FR: 2023-06-16, ES: 2024-03-22

Condition(s): severe to moderately severe hemophilia B (FIX:C ≤ 2%)
Product: fidanacogene elaparvovec

Primary endpoint: Non-inferiority on annualized bleeding rate (ABR) for total bleeds (treated and untreated) from Week 12 to Month 15 versus usual care FIX prophylaxis replacement regimen, comparing pre- and post-IP infusion
Endpoint(s): Non-inferiority on ABR for treated bleeds from Week 12 to Month 15 versus usual care FIX prophylaxis replacement regimen, comparing pre- and post-IP infusion, Annualized infusion rate (AIR) of exogenous FIX from Week 12 to Month 15 versus AIR of FIX with usual care FIX replacement regimen pre IP infusion, Vector derived FIX:C level at steady state (from Week 12 to 15 months) demonstrated to be greater than 5%. FIX:C will also be summarized descriptively by study visit, The following parameters will be compared with usual care FIX replacement regimen, comparing pre- and post-IP infusion from Week 12 to Month 15: •Annualized FIX consumption. • Annualized number of bleeding events of specific type: spontaneous and traumatic, and untreated. •Frequency of target joint bleeds. •Percentage of the participants without bleeds., The following parameters will be compared with usual care FIX replacement regimen, comparing pre- and post-IP infusion at 12 months: •Change in joint health as measured by the Hemophilia Joint Health Score (HJHS) instrument. •PRO instruments: •Haem A QoL Physical Health domain;•HAL Complex Lower Extremity Activities Component Score, Incidence and severity of adverse events collected during the study., Adverse Events of special interest: •Hypersensitivity reactions; • Clinical thrombotic events; • FIX inhibitors, • Hepatic malignancies. • Drug related elevated hepatic transaminases that fail to improve or resolve • Malignancy assessed as having reasonable possibility of being related to study drug, Other immunogenicity-based laboratory data including: immune response (presumed T-cell activation) to AAV capsid protein and/or FIX transgene, The following parameters will be assessed throughout the 6-year study period according to the SoA. Summaries will be provided for the overall follow-up period, as well as by yearly intervals: •Annualized Bleeding Rate for total bleeds (treated and untreated). • ABR for treated bleeds. •AIR of exogenous FIX. • Vector-derived FIX:C level by study visit and the geometric mean at each yearly interval., (continued from endpoint no. 9) • Annualized FIX consumption. • Annualized number of bleeding events of specific type: spontaneous and traumatic, and untreated. • HJHS total score. • Frequency of target joint bleeds. • PROs instruments. • Haem A QoL Physical Health domain. • HAL Complex Lower Extremity Activities Component Score.

Source: https://euclinicaltrials.eu/ctis-public/view/2022-502844-11-00